EU clinical trial 2022-502155-65-00: HydroxyChloroquine as steroid-sparing Agent in Extra-pulmonary SARcoidosis. A multicenter, prospective, placebo-controlled, randomized trial. CAESAR
Protocol code: 69HCL21_1054
Sponsor: Hospices Civils De Lyon (Hospital/Clinic/Other health care facility). Phase: Therapeutic confirmatory (Phase III). Countries: France (ongoing, recruiting).
Therapeutic area(s): Diseases [C] - Immune System Diseases [C20]
Gender: Female, Male. Age: 18-64 years, 65+ years. Enrolment: 140.
Status: Ongoing, recruiting. Start date (EU): 2024-07-30. Decision date: 2023-04-14. Results received: No. Last updated: 2026-02-27.

Condition(s): Extra pulmonary sarcoidosis
Product: PREDNISONE, Hydrogénophosphate de calcium dihydraté : Fournisseur Brenntag Stéarate de magnésium : Fournisseur Cooper Amidon de maïs : Fournisseur Barentz, PLAQUENIL 200 mg, comprimé pelliculé, PREDNISONE, PREDNISONE

Primary endpoint: The primary endpoint is the percentage of patients in remission and off prednisone at month 9, without relapse until month 12. The primary endpoint will thus be assessed at M12.
Endpoint(s): Organ-specific response assessed by calculation of the extrapulmonary Physician Organ Severity Tool (ePOST, previously validated in sarcoidosis RCT) at M0, M1, M3, M6, M12, M18, and M24, Global clinical response assessed by the physician as complete, partial, stable, or relapse (or progression) at M0, M1, M3, M6, M12, M18, and M24, Type, frequency and dosage of local steroid treatments, allowing cumulative doses calculation at M0, M1, M3, M6, M12, M18 and M24, Relapse rate until M24. Remission is defined by either complete or partial response. Relapse is defined as the persistence, or recurrence of existing manifestations and/or the occurrence of new sarcoidosis manifestations requiring substantial treatment modification, Frequencies of steroid-associated side-effects monitored clinically and biologically (BMI calculation, blood pressure measurement for arterial hypertension, dosages of glycaemia and HbA1c for diabetes mellitus, dosages of lipids, dosages of bone turnover markers for osteoporosis and clinical evaluation for infections) and Glucocorticoid Toxicity Index (GTI) will be calculated at M0, M1, M3, M6, M12, M18, and M24., HCQ safety will be assessed through initial and annual eye evaluation: electroretinogram or autofluorescence or OCT, and monitoring of eventual AEs. EKG will be performed before study initiation and at M1, M3, M6, M12, M18, and M24. An AE will be considered as serious if it leads to HCQ cessation, hospitalization, or death. Patients’ adherence will be controlled by patient notebooks, pharmacy count of unused tablets and serial dosages of blood HCQ levels (M6 and M12, Quality of life will be assessed by the SF36 questionnaire (Annex 16.1) HADS and FAS at M0, M1, M3, M6, M12, M18, and M24

Source: https://euclinicaltrials.eu/ctis-public/view/2022-502155-65-00